EU clinical trial 2023-504959-27-00: A Randomized, Double-blind, Placebo-controlled Phase 3 Study of Pembrolizumab (MK-3475) in Combination with Concurrent Chemoradiation Therapy Followed by Pembrolizumab with or without Olaparib (MK-7339), Compared to Concurrent Chemoradiation Therapy Alone in Participants with Newly Diagnosed Treatment-Naïve Limited-Stage Small Cell Lung Cancer (LS-SCLC)
Protocol code: MK-7339-013
Sponsor: Merck Sharp & Dohme LLC (Pharmaceutical company). Phase: Therapeutic confirmatory (Phase III). Countries: Portugal (ongoing, recruitment ended), Hungary (ongoing, recruitment ended), France (ongoing, recruitment ended), Romania (ongoing, recruitment ended), Belgium (ongoing, recruitment ended), Spain (ongoing, recruitment ended), Bulgaria (ongoing, recruitment ended), Estonia (ongoing, recruitment ended), Italy (ongoing, recruitment ended), Greece (ongoing, recruitment ended), Lithuania (ongoing, recruitment ended).
Therapeutic area(s): Diseases [C] - Neoplasms [C04]
Gender: Female, Male. Age: 18-64 years, 65+ years. Enrolment: 242.
Status: Ongoing, recruitment ended. Start date (EU): 2020-12-09. Decision date: 2023-12-12. Results received: No. Last updated: 2026-07-06.
Decision dates by country: ES: 2023-12-13, BE: 2023-12-14, EE: 2023-12-18, LT: 2024-01-30, GR: 2024-03-04, HU: 2023-12-13, FR: 2023-12-12, RO: 2023-12-13, BG: 2023-12-12, IT: 2023-12-18, PT: 2023-12-12

Condition(s): Participants with Limited Stage-Small Cell Lung Cancer, who have received no prior anticancer therapy for their disease.
Product: CISPLATIN, KEYTRUDA 25 mg/mL concentrate for solution for infusion, Olaparib, Olaparib matching placebo (tablet), ETOPOSIDE, CARBOPLATIN, Pembrolizumab placebo (saline), Olaparib

Primary endpoint: Progression-free Survival (PFS) Per Response Evaluation Criteria in Solid Tumors Version 1.1 (RECIST 1.1): the time from randomization to progression or death due to any cause, whichever occurs first, Overall Survival (OS): the time from randomization to death due to any cause
Endpoint(s): Number of Participants Experiencing an Adverse Events (AEs), Number of Participants Discontinuing Study Treatment Due to Adverse Events (AEs), Objective Response (OR): complete response (CR) or partial response (PR), Duration of Response (DOR): the time from the earliest date of first documented evidence of confirmed CR or PR until the earliest date of disease progression or death from any cause, whichever comes first, Change from Baseline at Cycle 1 in European Organization for Research and Treatment (EORTC) Quality of Life Questionnaire-Core 30 (QLQ-C30) Global Health Status / Quality of Life (Items 29 & 30) Scale Score, Change from Baseline at Cycle 1 in EORTC Quality of Life Questionnaire Lung Cancer Module 13 (QLQ-LC13) Cough (Item 1) Scale Score, Change from Baseline at Cycle 1 in EORTC QLQ-LC13 Chest Pain (Item 10) Scale Score, Change from Baseline at Cycle 1 in EORTC QLQ-C30 Dyspnea (Item 8) Scale Score, Change from Baseline at Cycle 1 in EORTC QLQ-C30 Physical Functioning (Items 1 to 5) Scale Score, Time to True Deterioration (TTD) in EORTC QLQ-C30 Global Health Status / Quality of Life (Items 29 & 30) Scale Score, Time to True Deterioration (TTD) in Cough (LC13/Item 1) Scale Score, Time to True Deterioration (TTD) in Chest Pain (LC13/Item 10) Scale Score, Time to True Deterioration (TTD) in EORTC QLQ-C30 Dyspnea (Item 8) Scale Score, Time to True Deterioration (TTD) in EORTC QLQ-C30 Physical Functioning (Items 1 to 5) Scale Score, Objective Response (OR, according to RECIST 1.1 by BICR) assessed by programmed cell death ligand 1 (PD-L1) expression levels, Duration of Response (DOR, according to RECIST 1.1 by BICR) assessed by programmed cell death ligand 1 (PD-L1) expression levels, Progression-free Survival (PFS, according to RECIST 1.1 by BICR) assessed by programmed cell death ligand 1 (PD-L1) expression levels, Overall Survival (OS) assessed by programmed cell death ligand 1 (PD-L1) expression levels

Source: https://euclinicaltrials.eu/ctis-public/view/2023-504959-27-00